EU clinical trial 2023-505887-12-00: A randomized, open-label, single dose, cross-over bioavailability study evaluating the drug-drug interaction between Tritace 10, 10 mg, tablets and Tertensif SR 1.5 mg prolonged-release film-coated tablets when co-administered versus the administration of each product alone in two cohorts of healthy volunteers under fasting conditions. Sponsor's Study No.: RAM-IND-DDI-05-23
Sponsor: Adamed Pharma S.A. (Pharmaceutical company). Phase: Human Pharmacology (Phase I)- Other. Countries: Czechia (ended).
Therapeutic area(s): Diseases [C] - Cardiovascular Diseases [C14]
Gender: Female, Male. Age: 18-64 years. Enrolment: 94.
Status: Ended. Start date (EU): 2023-09-13. End date (EU): 2023-11-16. Decision date: 2023-08-25. Results received: Yes. Last updated: 2023-08-28.

Condition(s): NA - study in healthy subjects
Product: Tertensif SR, 1,5 mg, tabletki powlekane o przedłużonym uwalnianiu, TRITACE 10, 10 mg, tabletki

Primary endpoint: To assess drug-drug interaction in all completed subjects out of 94 enrolled.
Endpoint(s): To evaluate the safety and tolerability of these formulations.

Source: https://euclinicaltrials.eu/ctis-public/view/2023-505887-12-00